EU clinical trial 2024-520379-28-00: Revised dosing of Ciprofloxacin for patients with impaired renal function: a bioequivalence study
Sponsor: Amsterdam UMC Stichting (Patient organisation/association). Phase: Therapeutic use (Phase IV). Countries: Netherlands (ongoing, recruiting).
Therapeutic area(s): Diseases [C] - Bacterial Infections and Mycoses [C01]
Gender: Female, Male. Age: 18-64 years, 65+ years. Enrolment: 58.
Status: Ongoing, recruiting. Start date (EU): 2025-01-24. Decision date: 2025-01-24. Results received: No. Last updated: 2025-01-24.

Condition(s): bacterial infection
Product: CIPROFLOXACIN

Primary endpoint: Drug exposure in the first 24 hours of treatment (AUC0- 24)

Source: https://euclinicaltrials.eu/ctis-public/view/2024-520379-28-00